EU clinical trial 2024-512321-84-00: Treatment of chemo-refractory viral infections after allogeneic stem cell transplantation with multispecific T cells against CMV, EBV and AdV: A phase III, prospective, multicentre clinical trial (TRACE)
Sponsor: Medical Center - University Of Freiburg (Hospital/Clinic/Other health care facility). Phase: Therapeutic confirmatory (Phase III). Countries: Belgium (ongoing, recruiting), Germany (ongoing, recruiting), Italy (ongoing, recruiting), France (ongoing, recruiting), Netherlands (ongoing, recruiting).
Therapeutic area(s): Diseases [C] - Virus Diseases [C02]
Gender: Female, Male. Age: 0-17 years, 18-64 years, 65+ years. Enrolment: 111.
Status: Ongoing, recruiting. Start date (EU): 2019-10-02. Decision date: 2024-07-02. Results received: No. Last updated: 2026-07-16.
Decision dates by country: DE: 2024-07-08, NL: 2024-07-02, BE: 2024-07-02, IT: 2024-08-07, FR: 2024-07-10

Condition(s): Patients after HSCT suffering from new or reactivated CMV or EBV or AdV infection, refractory to standard antiviral treatment
Product: Multivirus-specific T cells placebo, Allogeneic multivirus (CMV, EBV, AdV-) specific T cells

Primary endpoint: Percentage of patients with viral clearance (defined as two consecutive negative PCRs), Percentage of patients with progression between Day 7 and Week 8 after IMP transfer
Endpoint(s): Incidence/severity of acute GvHD ≥ grade II until Week 8 and Week 15., Incidence of newly occurring acute GvHD grade I from Day 0 to Week 8 and Week 15., Incidence of chronic GvHD from Day 7 to Week 8 and to Week 15 after IMP transfer., Time to newly occurring acute and chronic GvHD., Acute toxicity: maximum toxicity on the day of IMP transfer evaluated by measuring vital signs prior to and at different times after the IMP transfer and monitoring of specific adverse events (chills, nausea, vomiting, diarrhoea, abdominal pain, allergic reactions, respiratory dysfunction or headache from 1 hour prior to IMP transfer to 4 hours post infusion)., Change in viral load of underlying viral infection as assessed by quantitative PCR analysis of peripheral blood; samples taken weekly from Day 7 to Week 8 after IMP transfer as compared to samples taken at Day 0., Time to 1 log change in viral load., Percentage of patients with ≥1 log decrease in CMV, EBV or AdV viral load at Week 8., Number of reactivations of the underlying viral infection following initial viral clearance until end of follow-up., Number of patients with reduction or clearance of clinical symptoms of underlying viral infection from Day 7 to Week 8 after IMP transfer as compared to Day 0., Overall survival rate (OS): From Day 0 to end of follow-up., Number of days requiring antiviral chemotherapy after IMP transfer from Day 7 to Week 8 after IMP transfer., Time to last administration of defined antiviral medication or switch to prophylactic treatment from Day 0 to Week 8 after IMP transfer., Number of new viral reactivations (CMV, AdV or EBV) other than the underlying viral infection per patient as assessed by PCR analysis and clinical symptoms throughout the study., Number of days hospitalized after IMP transfer from Day 7 to Week 8., EQ-5D and FACT-BMT for adult patients (≥18 years), and PEDS-QL for paediatric patients (<18 years) at Screening and Week 8., T-cell phenotyping, samples taken at Screening, Day 0 and each visit from Day 7 to Week 15 after IMP transfer., Analysis of virus-specific T cells: frequencies of in vivo expanded virusspecific T cells in peripheral blood samples taken at Screening, Day 0, Day 7 to Week 15 after IMP transfer., Assessment of the number and viability of CD3+ cells and percentage of IFNgamma+ cells and cellular composition in the IMP., Drop-out rate at Day 0 and reasons for drop-out., Number of days from Screening to Day 0 (day of IMP transfer)., Documentation of incidence, severity and type of adverse events from Day 0 to Week 8 and serious adverse events throughout the study., Physical examination and vital signs from Screening to Week 8; Karnofsky/Lansky index will be assessed at Screening and at Week 8., Laboratory values for clinical chemistry and haematology from Screening to Week 8., Documentation of all concomitant medication from Screening to Week 8., During follow-up Week 15, only antiviral therapy, immunosuppression and SAErelated concomitant medication as well as chemotherapy will be documented., Non-therapeutic DLI has to be documented as concomitant medication (definition see exclusion criteria)., Treatment with T cells after Week 8 will also be documented as concomitant medication.

Source: https://euclinicaltrials.eu/ctis-public/view/2024-512321-84-00